EU clinical trial 2023-507304-32-00: THE ANTES B+ STUDY: AN OPEN-LABEL, PRAGMATIC, RANDOMIZED, CONTROLLED TRIAL OF TRIPLE THERAPY VERSUS LABA-LAMA COMBINATION TO IMPROVE CLINICAL CONTROL IN HIGH-RISK GOLD B PATIENTS (B+)
Protocol code: ANTES B+
Sponsor: Fundacio Privada Mon Clinic Barcelona (Laboratory/Research/Testing facility). Phase: Therapeutic use (Phase IV). Countries: Spain (ended).
Therapeutic area(s): Diseases [C] - Respiratory Tract Diseases [C08]
Gender: Female, Male. Age: 18-64 years, 65+ years. Enrolment: 1028.
Status: Ended. Start date (EU): 2024-02-09. End date (EU): 2025-01-23. Decision date: 2023-11-22. Results received: Yes. Last updated: 2024-04-04.

Condition(s): Chronic Obstructive Pulmonary Disease
Product: Xoterna Breezhaler 85 micrograms/43 micrograms inhalation powder hard capsules, LAVENTAIR ELLIPTA 55 micrograms/22 micrograms inhalation powder, pre-dispensed, Ultibro Breezhaler 85 micrograms/43 micrograms inhalation powder hard capsules, Tovanor Breezhaler 44 micrograms inhalation powder, hard capsules, Ultibro Breezhaler 85 micrograms/43 micrograms inhalation powder hard capsules, Oslif Breezhaler 300 microgram inhalation powder, hard capsules, Ulunar Breezhaler 85 micrograms/43 micrograms inhalation powder hard capsules, Onbrez Breezhaler 300 microgram inhalation powder, hard capsules, Spiolto Respimat 2,5 microgramos/2,5 microgramos, solución para inhalación, ANORO ELLIPTA 55 micrograms/22 micrograms inhalation powder, pre-dispensed, Seebri Breezhaler 44 micrograms inhalation powder, hard capsules, Enurev Breezhaler 44 micrograms inhalation powder, hard capsules, Sirkava 18 microgramos polvo para inhalación (cápsula dura), Brimica Genuair 340 micrograms /12 micrograms inhalation powder, Beglan Accuhaler 50 microgramos/inhalación, polvo para inhalación., Brimica Genuair 340 micrograms /12 micrograms inhalation powder, Seebri Breezhaler 44 micrograms inhalation powder, hard capsules, Ulunar Breezhaler 85 micrograms/43 micrograms inhalation powder hard capsules, Formoterol STADA 12 mcg polvo para inhalación, Trelegy Ellipta 92 micrograms/55 micrograms/22 micrograms inhalation powder, pre-dispensed, Oslif Breezhaler 300 microgram inhalation powder, hard capsules, Duaklir Genuair 340 micrograms /12 micrograms inhalation powder, Hirobriz Breezhaler 300 microgram inhalation powder, hard capsules, Xoterna Breezhaler 85 micrograms/43 micrograms inhalation powder hard capsules, Tovanor Breezhaler 44 micrograms inhalation powder, hard capsules, Eklira Genuair 322 micrograms inhalation powder, Gregal 10 microgramos/dosis liberada polvo para inhalación (cápsula dura), Beglan 25 microgramos/inhalación, suspensión para inhalación en envase a presión, Spiriva 18 microgramos polvo para inhalación, Betamican® Accuhaler® 50 microgramos/inhalación, polvo para inhalación, Xoterna Breezhaler 85 micrograms/43 micrograms inhalation powder hard capsules, Hirobriz Breezhaler 300 microgram inhalation powder, hard capsules, Enurev Breezhaler 44 micrograms inhalation powder, hard capsules, Xoterna Breezhaler 85 micrograms/43 micrograms inhalation powder hard capsules, Onbrez Breezhaler 300 microgram inhalation powder, hard capsules, Ulunar Breezhaler 85 micrograms/43 micrograms inhalation powder hard capsules, Seebri Breezhaler 44 micrograms inhalation powder, hard capsules, Serevent 25 microgramos/inhalación, suspensión para inhalación en envase a presión, Ultibro Breezhaler 85 micrograms/43 micrograms inhalation powder hard capsules, Xoterna Breezhaler 85 micrograms/43 micrograms inhalation powder hard capsules, Formoterol Aldo-Unión 12 microgramos polvo para inhalación (cápsulas duras), Ulunar Breezhaler 85 micrograms/43 micrograms inhalation powder hard capsules, Yanimo Respimat 2,5 microgramos/2,5 microgramos, solución para inhalación, Spiriva Respimat 2,5 microgramos, solución para inhalación, Incruse Ellipta 55 micrograms inhalation powder, pre-dispensed, Soltel 25 microgramos/inhalación suspensión para inhalación en envase a presión, Inaspir 25 microgramos/inhalación, suspensión para inhalación en envase a presión, Formatris Novolizer® 12 microgramos/dosis polvo para inhalación, FORADIL Aerolizer 12 microgramos polvo para inhalación (cápsula dura), Betamican 25 microgramos/inhalación, suspensión para inhalación en envase a presión, Bretaris Genuair 322 micrograms inhalation powder, Ulunar Breezhaler 85 micrograms/43 micrograms inhalation powder hard capsules, Tovanor Breezhaler 44 micrograms inhalation powder, hard capsules, Rolufta Ellipta 55 micrograms inhalation powder, pre-dispensed, Ulunar Breezhaler 85 micrograms/43 micrograms inhalation powder hard capsules, Braltus 10 microgramos/dosis liberada polvo para inhalación (cápsula dura), Ulunar Breezhaler 85 micrograms/43 micrograms inhalation powder hard capsules, Onbrez Breezhaler 300 microgram inhalation powder, hard capsules, Trelegy Ellipta 92 micrograms/55 micrograms/22 micrograms inhalation powder, pre-dispensed, Enurev Breezhaler 44 micrograms inhalation powder, hard capsules, Duaklir Genuair 340 micrograms /12 micrograms inhalation powder, Tovanor Breezhaler 44 micrograms inhalation powder, hard capsules, Ultibro Breezhaler 85 micrograms/43 micrograms inhalation powder hard capsules, Rolufta Ellipta 55 micrograms inhalation powder, pre-dispensed, Brimica Genuair 340 micrograms /12 micrograms inhalation powder, Seebri Breezhaler 44 micrograms inhalation powder, hard capsules, Xoterna Breezhaler 85 micrograms/43 micrograms inhalation powder hard capsules, Seebri Breezhaler 44 micrograms inhalation powder, hard capsules, Ultibro Breezhaler 85 micrograms/43 micrograms inhalation powder hard capsules, Eklira Genuair 322 micrograms inhalation powder, Incruse Ellipta 55 micrograms inhalation powder, pre-dispensed, Bretaris Genuair 322 micrograms inhalation powder, OXIS TURBUHALER 4,5 microgramos/inhalación polvo para inhalación., Tovanor Breezhaler 44 micrograms inhalation powder, hard capsules, Oslif Breezhaler 300 microgram inhalation powder, hard capsules, Rolufta Ellipta 55 micrograms inhalation powder, pre-dispensed, Ultibro Breezhaler 85 micrograms/43 micrograms inhalation powder hard capsules, Seebri Breezhaler 44 micrograms inhalation powder, hard capsules, Tavulus 18 microgramos polvo para inhalación (cápsula dura), Hirobriz Breezhaler 300 microgram inhalation powder, hard capsules, Serevent® Accuhaler® 50 microgramos/inhalación, polvo para inhalación, Broncoral Neo 12 microgramos/pulsación, Solución para inhalación en envase a presión., OXIS TURBUHALER 9 microgramos/inhalación polvo para inhalación., Inaspir Accuhaler 50 microgramos/inhalación, polvo para inhalación., Oslif Breezhaler 300 microgram inhalation powder, hard capsules, LAVENTAIR ELLIPTA 55 micrograms/22 micrograms inhalation powder, pre-dispensed, Xoterna Breezhaler 85 micrograms/43 micrograms inhalation powder hard capsules, Striverdi Respimat 2,5 microgramos, solución para inhalación, Trelegy Ellipta 92 micrograms/55 micrograms/22 micrograms inhalation powder, pre-dispensed, Duaklir Genuair 340 micrograms /12 micrograms inhalation powder, ANORO ELLIPTA 55 micrograms/22 micrograms inhalation powder, pre-dispensed, Enurev Breezhaler 44 micrograms inhalation powder, hard capsules, Bretaris Genuair 322 micrograms inhalation powder, Ultibro Breezhaler 85 micrograms/43 micrograms inhalation powder hard capsules, Incruse Ellipta 55 micrograms inhalation powder, pre-dispensed, Ultibro Breezhaler 85 micrograms/43 micrograms inhalation powder hard capsules, Ulunar Breezhaler 85 micrograms/43 micrograms inhalation powder hard capsules, Xoterna Breezhaler 85 micrograms/43 micrograms inhalation powder hard capsules, LAVENTAIR ELLIPTA 55 micrograms/22 micrograms inhalation powder, pre-dispensed, Seebri Breezhaler 44 micrograms inhalation powder, hard capsules, Enurev Breezhaler 44 micrograms inhalation powder, hard capsules, Hirobriz Breezhaler 300 microgram inhalation powder, hard capsules, Enurev Breezhaler 44 micrograms inhalation powder, hard capsules, Seebri Breezhaler 44 micrograms inhalation powder, hard capsules, Onbrez Breezhaler 300 microgram inhalation powder, hard capsules, Onbrez Breezhaler 300 microgram inhalation powder, hard capsules, Tovanor Breezhaler 44 micrograms inhalation powder, hard capsules, Eklira Genuair 322 micrograms inhalation powder, Hirobriz Breezhaler 300 microgram inhalation powder, hard capsules, Enurev Breezhaler 44 micrograms inhalation powder, hard capsules, Oslif Breezhaler 300 microgram inhalation powder, hard capsules, Enurev Breezhaler 44 micrograms inhalation powder, hard capsules, Tovanor Breezhaler 44 micrograms inhalation powder, hard capsules, Tovanor Breezhaler 44 micrograms inhalation powder, hard capsules

Primary endpoint: To determine the existence of an association between the use of Trelegy® vs. LABA-LAMA treatment with being a patient persistently controlled by CC at all study visits (a subject to be a categorize as having clinical control they must meet the criteria at month 3, 6, 9 and 12).
Endpoint(s): To determine the existence of an association between the use of Trelegy® vs. LABA-LAMA treatment with being a patient persistently non deteriorated by CID-CAT at all study visits.(a subject to be a categorize as having control by CID-CAT they must meet the criteria a month 3, 6, 9 and 12)., To compare several Health status related endpoints between study arms including the existence of an association between the use of Trelegy vs. LABA-LAMA treatment with being a patient persistenly controlled (at all visits) throughout the study between the two study arms as per CC - Stability Domain (1.General status since the last visit and 2. Exacerbations in the last 3 months), To compare several Health status related endpoints between study arms including the existence of an association between the use of Trelegy vs. LABA-LAMA treatment with being a patient persistenly controlled (at all visits) throughout the study between the two study arms as per CC - Impact Domain (1.Sputum color, 2. Rescue Medication, 3. Minute walked per day and 4. Dyspnea (mMRC))), To compare several Health status related endpoints between study arms including the existence of an association between the use of Trelegy vs. LABA-LAMA treatment with being a patient persistenly controlled (at all visits) throughout the study between the two study arms as per CID-CAT – Exacerbations, To compare several Health status related endpoints between study arms including the existence of an association between the use of Trelegy vs. LABA-LAMA treatment with being a patient persistenly controlled (at all visits) throughout the study between the two study arms as per CID-CAT – PROs, To compare several Health status related endpoints between study arms including the existence of an association between the use of Trelegy vs. LABA-LAMA treatment with being a patient persistenly controlled (at all visits) throughout the study between the two study arms as per CID-CAT – Lung function, To compare several Health status related endpoints between study arms including: To evaluate time to first not being CC or suffer CID-CAT, To compare several Health status related endpoints between study arms including evaluate the time to first not achievement event for CC - Stability Domain (1. General status since the last visit and 2. Exacerbations in the last 3 months), To compare several Health status related endpoints between study arms including evaluate the time to first not achievement event for CC - Impact Domain (1. Sputum color, 2. Rescue medication use, 3. Minutes walked per day and 4. Dyspnea (mMRC)), To compare several Health status related endpoints between study arms including evaluate the time to first not achievement event for CID-CAT Exacerbations, To compare several Health status related endpoints between study arms including evaluate the time to first not achievement event for CID-CAT Spirometry, To compare several Health status related endpoints between study arms including to evaluate the mean and annual rate of: 1. Moderate exacerbations (ECOPD), 2. Severe ECOPD (hospitalized) and 3. Moderate and Severe ECOPD, To compare several Health status related endpoints between study arms including to evaluate time to first ECOPD including: 1. Moderate ECOPD, 2. Severe ECOPD (hospitalized) and 3. Moderate to Severe ECOPD, To compare several Health status related endpoints between study arms including to assess annual FEV1 and FVC changes (ml/year), To identify independent predictors with a potential negative impact on achieving the CC, each of its domains and each of its variables at each study visit.

Source: https://euclinicaltrials.eu/ctis-public/view/2023-507304-32-00